EU clinical trial 2024-519183-40-00: Receptor radionuclide therapy with 177Lu-DOTATOC (177Lu- edotreotide or 177Lu-octreotide) in SSTR positive patients: a multicenter, prospective, phase II trial
Protocol code: IRST100.60
Sponsor: Istituto Romagnolo Per Lo Studio Dei Tumori Dino Amadori IRST S.r.l. (Hospital/Clinic/Other health care facility). Phase: Therapeutic exploratory (Phase II). Countries: Italy (authorised, recruitment pending).
Therapeutic area(s): Diseases [C] - Neoplasms [C04]
Gender: Female, Male. Age: 18-64 years, 65+ years. Enrolment: 178.
Status: Authorised, recruitment pending. Decision date: 2025-01-13. Results received: No. Last updated: 2026-04-10.

Condition(s): NET, Neuroendocrine Tumor, Other SSTR-positive tumours, NETs retreated with PRRT, Pheochromocytomas and paragangliomas, Bronchopulmonary and other NETs

Primary endpoint: The primary endpoint is DCR, defined as the percentage of patients who have achieved complete response, partial response, stable disease (according to RECIST 1.1) at the 1st planned evaluation
Endpoint(s): Safety was evaluated according to version 5.0 CTC-AE. Safety is defined as the percentage of patients who experience acute toxicity from the 1st treatment until 30 days after the last treatment cycle or late toxicity that occurred after 30 days from the last treatment administration up to 6 months, PFS is defined as the time from the start treatment date to the date of first observation of documented disease progression or death due to any cause. Patients without tumor progression at the time of analysis will be censored at their last date of tumor evaluation, Overall survival is defined as the time from the therapy start to the date of death due to any cause or the date of last contact (censored observation) at the date of data cut-off, Quality of life will be evaluated through validated standardised data collection forms from the EORTC QLQ-C30 questionnaire. QoL will be collected at baseline, at every cycle of treatment start and at end of treatment

Source: https://euclinicaltrials.eu/ctis-public/view/2024-519183-40-00